EU clinical trial 2024-516005-23-00: SPARTANA : Spartalizumab, mDCF (docetaxel, cisplatin and 5-fluorouracil) and radiotherapy in patients with metastatic squamous cell anal carcinoma. A Phase IIA study
Sponsor: Centre Hospitalier Regional Universitaire (Hospital/Clinic/Other health care facility). Phase: Therapeutic exploratory (Phase II). Countries: France (ended).
Therapeutic area(s): Diseases [C] - Digestive System Diseases [C06]
Gender: Female, Male. Age: 18-64 years, 65+ years. Enrolment: 34.
Status: Ended. Start date (EU): 2024-08-22. End date (EU): 2026-05-29. Decision date: 2024-08-22. Results received: No. Last updated: 2024-08-22.

Condition(s): metastatic squamous cell anal carcinoma
Product: DOCETAXEL, PDR001, CISPLATIN, MITOMYCIN, FLUOROURACIL

Primary endpoint: The primary endpoint is the Progression Free Survival (PFS) rate at 1 year evaluated by RECIST criteria v1.1. PFS rate at 1 year is defined as the number of patients alive without progression at 1 year divided by the overall number of patients evaluable for PFS status at 1 year.

Source: https://euclinicaltrials.eu/ctis-public/view/2024-516005-23-00